EU clinical trial 2022-502911-12-00: A Phase 1/2, Global, Open-Label, Extension Study to Evaluate the Long-Term Safety and Clinical Activity of mRNA-3927 in Participants Previously Enrolled in the mRNA-3927-P101 Study
Protocol code: mRNA-3927-P101-EXT
Sponsor: Moderna Inc. (Pharmaceutical company). Phase: Phase I and Phase II (Integrated)- Other. Countries: Spain (ongoing, recruiting), Netherlands (authorised, recruitment pending), France (ongoing, recruiting).
Therapeutic area(s): Diseases [C] - Nutritional and Metabolic Diseases [C18]
Gender: Female, Male. Age: 0-17 years, 18-64 years. Enrolment: 13.
Start date (EU): 2026-06-26. Decision date: 2026-02-23. Results received: No. Last updated: 2026-07-10.
Decision dates by country: ES: 2026-02-24, FR: 2026-02-23, NL: 2026-02-27

Condition(s): Propionic Acidemia
Product: mRNA-3927

Primary endpoint: Incidence and severity of AEs (including mRNA-3927 -related and not related AEs), SAEs, and AEs leading to treatment discontinuation.
Endpoint(s): Annualized frequency of Investigator-reported MDEs., Annualized frequency of Investigator-reported MDE-related hospitalizations., Annualized frequency of Investigator-reported PA-related hospitalizations., Annualized frequency of Investigator-reported PA-related urgent healthcare encounters.

Source: https://euclinicaltrials.eu/ctis-public/view/2022-502911-12-00